EU clinical trial 2023-507617-96-01: Early shift to oral antibiotic treatment of pyogenic vertebral osteomyelitis – a open label non-inferiority randomized nationwide study.
Sponsor: Rigshospitalet (Hospital/Clinic/Other health care facility). Phase: Therapeutic use (Phase IV). Countries: Denmark (ongoing, recruiting).
Therapeutic area(s): Diseases [C] - Musculoskeletal Diseases [C05]; Diseases [C] - Bacterial Infections and Mycoses [C01]
Gender: Female, Male. Age: 18-64 years, 65+ years. Enrolment: 374.
Status: Ongoing, recruiting. Start date (EU): 2024-02-14. Decision date: 2023-11-27. Results received: No. Last updated: 2026-05-22.

Condition(s): Pyogenic vertebral osteomyelitis
Product: PHENOXYMETHYLPENICILLIN, SULFAMETHOXAZOLE AND TRIMETHOPRIM, CLOXACILLIN, MEROPENEM, AMOXICILLIN AND BETA-LACTAMASE INHIBITOR, MOXIFLOXACIN, CEFTRIAXONE, LINEZOLID, VANCOMYCIN, Bactrim 400 mg/80 mg tabletter, DICLOXACILLIN, CIPROFLOXACIN, CEFUROXIME, AMPICILLIN, CLINDAMYCIN, AMOXICILLIN, FUCIDINE 250 mg, comprimé pelliculé, RIFAMPICIN, BENZYLPENICILLIN, FLUCLOXACILLIN

Primary endpoint: A composite of the following occurring from randomization to six months after completion of oral AB •All-cause mortality •Unplanned surgical intervention in relation to the spine and paravertebral tissue including the illopsoas muscle for treatment of PVO. •Relapse bacteremia with primary pathogen •Relapse of bacteria with the initial pathogen cultured from relevant material from infected areas in relation to the spine or iliopsoas • Renewed course of IV ABs given for >7 days for PVO
Endpoint(s): Occurrence of each component of the composite primary endpoint from randomization to six months after completion of oral AB treatment., Median duration of hospital admission(s) from the time of randomization to six months after completion of oral AB treatment (Admission defined as overnight stay at the department), Number of readmissions from the time of randomization to six months after completion of oral AB treatment, Proportion of patients receiving additional oral AB therapy beyond the duration defined in the protocol, Proportion of patients having early termination of allocated treatment strategy due to adverse events, patient preference, or any other reason, Proportion of patients experiencing complications associated with IV treatment (e.g., catheter infections, phlebitis, bleeding, venous thrombosis, need for replacement of catheter) from the time of initiation of IV treatment for PVO to six months after completion of oral AB treatment, Proportion of patients experiencing severe adverse events from ABs from randomization to six months after completion of oral AB treatment, Proportion of patients diagnosed with Clostridioides difficile associated diarrhea from randomization to six months after completion of oral AB treatment, Quality of life scores (EQ-5D) at the following timepoints: Randomization, 1 week after the end of AB therapy, 6 months after the end of oral AB therapy, and 12 months after the end of oral AB therapy, Resource allocation/cost assessment determined by a combination of EQ5D, DALYs, Days of hospital admission and antibiotic prescribing costs, CRP and WBC at randomization as well as CRP and WBC weekly during treatment and at week 4, 12 and 24 after completion of oral AB treatment., Presence of microbial cell-free DNA in blood samples at the time of randomization and 6 months after the end of oral AB therapy, Proportion of patients given more than 5 days IV antibiotic therapy during the oral antibiotic-treatment phase for an unrelated intercurrent illness, or if the patient experiences vomiting or is unable to swallow, or concerns arise about absorption of oral medication.

Source: https://euclinicaltrials.eu/ctis-public/view/2023-507617-96-01